EU clinical trial 2025-524289-56-00: A pragmatic, phase IV, randomized, open-label, multinational, multicentre, 2-arm parallel group, prospective study comparing efficacy and safety of Single Inhaler ICS/LABA/LAMA (beclometasone/formoterol fumarate/glycopyrronium bromide [87/5/9 pMDI {BD/FF/GB - 100/6/12.5 µg}]) vs Single Inhaler ICS/LABA (beclometasone dipropionate plus formoterol fumarate [200/6 pMDI {BD/FF - 200/6 µg}]) in asthma subjects.
Protocol code: CLI-05993AB1-08
Sponsor: Chiesi Farmaceutici S.p.A. (Pharmaceutical company). Phase: Therapeutic use (Phase IV). Countries: Germany (authorised, recruitment pending), Romania (authorised, recruitment pending), Italy (authorised, recruitment pending), Bulgaria (authorised, recruitment pending), Poland (authorised, recruitment pending), Slovakia (authorised, recruitment pending), Spain (authorised, recruitment pending), France (authorised, recruitment pending).
Therapeutic area(s): Diseases [C] - Respiratory Tract Diseases [C08]
Gender: Female, Male. Age: 18-64 years, 65+ years. Enrolment: 606.
Status: Authorised, recruitment pending. Decision date: 2026-05-18. Results received: No. Last updated: 2026-06-24.
Decision dates by country: ES: 2026-05-25, FR: 2026-05-20, DE: 2026-05-19, IT: 2026-05-18, RO: 2026-05-25, SK: 2026-05-18, BG: 2026-05-20, PL: 2026-05-25

Condition(s): Asthma
Product: Trimbow 87 micrograms/5 micrograms/9 micrograms pressurised inhalation, solution, Fostair 200 microgram/6 microgram per actuation pressurised inhalation solution

Primary endpoint: 1. Change from baseline in ACQ-5 at Visit 7
Endpoint(s): 1. Change from baseline in ACQ-5 at all applicable visits., 2. Rate of severe asthma exacerbations during the 12-month treatment period including specific analysis at 6 and 12 months., 3. Rate of moderate/severe asthma exacerbations during the 12-month treatment period including specific analysis at 6 and 12 months., 4. Time-to-first severe asthma exacerbation., 5. Time-to-first moderate/severe asthma exacerbation., 6. Speed of change questionnaire at each applicable study visit., 7. Change from baseline in eosinophils value at each applicable study visit., 8. Number of days and total dose with oral systemic corticosteroids during the 12-month treatment period., 9. Change from baseline in Test of the Adherence to Inhalers questionnaire at each applicable visit., 10. Change from baseline in spirometry parameters at each applicable on-site visit., 11. Change from baseline in oscillometry parameters at each applicable on-site visit., 12. Change from baseline in quality of life questionnaire (EuroQol 5-Dimension 5-Level questionnaire; EQ-5D-5L) at each applicable visit., 13. Change from baseline in chronic airways assessment test questionnaire at each applicable visit., 14. Percentage of study participants with cardiovascular and/or fatal events (considering standard adverse event [AE] data collection)., 15. Percentage of study participants with Asthma Remission (Partial** and Complete Remission*) at 6 and 12 months., 15. *Complete Clinical Asthma Remission is defined as: a) No systemic corticosteroid intake at the timepoint (i.e. 6 or 12 months). b) No severe asthma exacerbation occurrence before the timepoint (i.e. 6 or 12 months). c) ACQ-5 ≤1.5 at the timepoint (i.e. 6 or 12 months). d) Change from baseline (i.e. Visit 1) in predose (12 hours from last administration) forced expiratory volume in 1 second at the timepoint (i.e. 6 or 12 months ≥0 mL)., 15. ** Partial Clinical Asthma Remission is defined as: -No systemic corticosteroid intake at the timepoint (i.e. 6 or 12 months). -Two of the other 3 criteria are met (b, c, d).

Source: https://euclinicaltrials.eu/ctis-public/view/2025-524289-56-00